EU clinical trial 2023-503421-19-00: C5701003 - An open-label, randomized, controlled phase 3 study of enfortumab vedotin in combination with pembrolizumab versus chemotherapy alone in previously untreated locally advanced or metastatic urothelial cancer
Protocol code: C5701003
Sponsor: Seagen Inc. (Pharmaceutical company). Phase: Therapeutic confirmatory (Phase III). Countries: Germany (ongoing, recruitment ended), Hungary (ongoing, recruitment ended), Belgium (ongoing, recruitment ended), Denmark (ongoing, recruitment ended), Czechia (ongoing, recruitment ended), Netherlands (ongoing, recruitment ended), Spain (ongoing, recruitment ended), Italy (ongoing, recruitment ended), France (ongoing, recruitment ended), Poland (ongoing, recruitment ended).
Therapeutic area(s): Diseases [C] - Neoplasms [C04]
Gender: Female, Male. Age: 18-64 years, 65+ years. Enrolment: 703.
Status: Ongoing, recruitment ended. Start date (EU): 2020-08-26. Decision date: 2023-11-10. Results received: No. Last updated: 2026-07-03.
Decision dates by country: PL: 2023-12-15, ES: 2023-11-13, DK: 2023-11-10, FR: 2023-11-28, IT: 2023-11-17, NL: 2023-11-13, BE: 2023-11-10, HU: 2023-11-10, CZ: 2023-11-15, DE: 2023-11-17

Condition(s): Urothelial cancer
Product: KEYTRUDA 25 mg/mL concentrate for solution for infusion, Cisplatin 1 mg/ml Concentrate for Solution for Infusion, CARBOPLATINE ACCORD 10 mg/ml, solution pour perfusion, Gemcitabin AqVida 38 mg/ml Pulver zur Herstellung einer Infusionslösung, CISPLATINE ACCORD 1 mg/ml, solution à diluer pour perfusion, Padcev 30 mg powder for concentrate for solution for infusion, Carboplatin 10 mg/ml concentrate for solution for infusion

Primary endpoint: 1. PFS per RECIST v1.1 by BICR., 2. OS.
Endpoint(s): 1. ORR per RECIST v1.1 by BICR., 2. TTPP., 3. Mean change from baseline in worst pain at Week 26., 4. PFS per RECIST v1.1 by investigator assessment., 5. ORR per RECIST v1.1 by investigator assessment., 6. DOR per RECIST v1.1 by BICR., 7. DOR per RECIST v1.1 by investigator assessment., 8. DCR per RECIST v1.1 by BICR., 9. DCR per RECIST v1.1 by investigator assessment., 10. Mean scores and change from baseline of the European Organisation for Research and Treatment of Cancer (EORTC) Quality of Life Core 30 (QLQ-C30), and EuroQOL 5-dimensions (EQ-5D-5L), visual analogue scale (VAS), and utility scores., 11. Type, incidence, relatedness, severity and seriousness of AEs., 12. Type, incidence and severity of laboratory abnormalities., 13. Treatment discontinuation rate due to AEs.

Source: https://euclinicaltrials.eu/ctis-public/view/2023-503421-19-00